EU clinical trial 2024-510656-13-00: Interventional, randomized, double-blind, parallel-group, placebo-controlled study to evaluate the efficacy and safety of IV eptinezumab in adolescents (12-17years) for the preventive treatment of chronic migraine.
Protocol code: 19356A
Sponsor: H. Lundbeck A/S (Pharmaceutical company). Phase: Therapeutic confirmatory (Phase III). Countries: Spain (ongoing, recruiting), Portugal (ongoing, recruiting), Italy (ongoing, recruiting), Poland (ongoing, recruiting).
Therapeutic area(s): Diseases [C] - Nervous System Diseases [C10]
Gender: Female, Male. Age: 0-17 years. Enrolment: 174.
Status: Ongoing, recruiting. Start date (EU): 2022-11-08. Decision date: 2024-09-13. Results received: No. Last updated: 2026-07-24.
Decision dates by country: PL: 2025-06-23, IT: 2024-09-23, ES: 2024-09-13, PT: 2024-09-17

Condition(s): Migraine
Product: Nacl 0.9%, VYEPTI 100 mg concentrate for solution for infusion

Primary endpoint: "Change From Baseline in Monthly Migraine Days (MMDs) Averaged Over Weeks 1-12 "
Endpoint(s): Percentage of Participants With 50% Reduction From Baseline in MMDs Averaged Over Weeks 1-12, Percentage of Participants With Migraine on the Day After Dosing (Day 1), Change From Baseline in MMDs With Use of Acute Medication Averaged Over Weeks 1-12, Percentage of Participants With 75% Reduction From Baseline in MMDs Averaged Over Weeks 1-12, Percentage of Participants With 75% Reduction From Baseline in MMDs Averaged Over Weeks 1-4, Percentage of Participants With 50% Reduction From Baseline in MMDs Averaged Over Weeks 1-4, Change From Baseline in Monthly Headache Days Averaged Over Weeks 1-12, Change From Baseline in Rate of Migraines With Severe Pain Intensity Averaged Over Weeks 1-12, Change From Baseline in Days With Use of Acute Medication Averaged Over Weeks 1-12, Change From Baseline in Pediatric Migraine Disability Assessment Questionnaire (PedMIDAS) Score Averaged Over Weeks 1-12, Free Eptinezumab Plasma Concentration, Number of Participants With Specific Anti-Eptinezumab Antibodies (Anti-Drug Antibodies [ADA]), Number of Participants With Specific Anti-Eptinezumab Antibodies for Neutralizing Activity (NAb)

Source: https://euclinicaltrials.eu/ctis-public/view/2024-510656-13-00